EU clinical trial 2024-518969-98-00: A Phase 3, Multi-Center, Randomized, Parallel, Double Masked, Placebo-Controlled Clinical Study to Assess the Safety and Efficacy of 0.1% RGN-259 Ophthalmic Solution for the Treatment of Neurotrophic Keratopathy (SEER-2)
Protocol code: RGN-NK-302
Sponsor: Regentree LLC (Pharmaceutical company). Phase: Therapeutic confirmatory (Phase III). Countries: Italy (ended), Poland (ended), Spain (ended).
Therapeutic area(s): Diseases [C] - Eye Diseases [C11]
Gender: Female, Male. Age: 18-64 years, 65+ years. Enrolment: 35.
Status: Ended. Start date (EU): 2025-11-04. End date (EU): 2026-06-30. Decision date: 2025-03-13. Results received: No. Last updated: 2026-06-09.
Decision dates by country: PL: 2025-03-24, ES: 2025-03-13, IT: 2025-03-18

Condition(s): Neurotrophic Keratopathy
Product: The placebo matches the test product with identical composition (with the exclusion of the active ingredient, timbetasin acetate), manufactured using the same process and package in the same container closure system., Timbetasin acetate ophthalmic solution 0.1%

Primary endpoint: Percentage of subjects achieving complete healing (defined as 0 mm lesion size) of the Persistent Epithelial Defect (PED) at Visit 5 (Day 29) determined by corneal fluorescein staining as measured by the Central Reading Center. The size of the lesion is based on the longest dimension (length or width) of the defect
Endpoint(s): Percentage of subjects achieving complete healing (defined as <0.5 mm lesion size) of the PED determined by corneal fluorescein staining as measured by the Investigator at Visit 5 (Day 29), Percentage of subjects achieving complete healing (defined as 0 mm lesion size) of the PED determined by corneal fluorescein staining as measured by the Central Reading Center at Visits 2, 3, 4, 6, and 7, Percentage of subjects achieving complete healing (defined as <0.5 mm lesion size) of the PED determined by corneal fluorescein staining as measured by the Investigator at Visits 2, 3, 4, 6, and 7, Percentage change from baseline of lesion size determined by corneal fluorescein staining as measured by the Central Reading Center at Visit 2-7 (measurements of greatest dimension of fluorescein staining), Percentage change from baseline of lesion size determined by corneal fluorescein staining as measured by the Investigator at Visit 2-7 (measurements of greatest dimension of fluorescein staining), NK stage (Mackie Classification) determined by corneal fluorescein staining as measured by the Investigator at Visits 2-7, Visual Acuity determined by Early Treatment of Diabetic Retinopathy Study (ETDRS) at Visits 2-7, Corneal sensitivity inside the lesion determined by Cochet-Bonnet aesthesiometer at Visits 2-7, Change from baseline in Ocular discomfort, Photophobia, Foreign body sensation, Burning and Dryness using VAS at Visit 3 and Visit 5., Change from baseline in Frequency of symptoms and severity of symptoms in SANDE questionnaire at Visit 3 and Visit 5., Proportion of subjects achieving complete healing (defined as 0 mm lesion size) of the PED determined by corneal fluorescein staining as measured by the Central Reading Center over multiple visits from visit 2 to visit 5, Proportion of subjects achieving complete healing (defined as <0.5 mm lesion size) of the PED determined by corneal fluorescein staining as measured by the Investigator over multiple visits from visit 2 to visit 5

Source: https://euclinicaltrials.eu/ctis-public/view/2024-518969-98-00